EU clinical trial 2024-517387-37-00: Metformin for Abdominal Aortic Aneurysm Inhibition (MAAAGI) A randomized controlled trial
Protocol code: MAAAGI
Sponsor: Uppsala University (Educational Institution). Phase: Therapeutic exploratory (Phase II). Countries: Sweden (ongoing, recruiting), Netherlands (ongoing, recruiting), Denmark (ongoing, recruiting).
Therapeutic area(s): Diseases [C] - Cardiovascular Diseases [C14]
Gender: Female, Male. Age: 18-64 years, 65+ years. Enrolment: 500.
Status: Ongoing, recruiting. Start date (EU): 2019-12-12. Decision date: 2024-11-11. Results received: No. Last updated: 2024-11-15.
Decision dates by country: SE: 2024-11-12, DK: 2024-11-15, NL: 2024-11-11

Condition(s): Small abdominal aortic aneurysm (AAA) under active surveillance; 30-49 mm in diameter for men and 30-44 mm in diameter for women
Product: METFORMIN

Primary endpoint: To examine if 2 g metformin administered daily over a five-year period slows AAA growth rate in patients with small AAAs who do not have diabetes mellitus measured as computed tomography (CT) imaging assessed AAA diameter. Measured at baseline versus 24 and 60 months of treatment.
Endpoint(s): To examine if metformin; a) limits increase in CT-assessed AAA volume; b) ultrasound assessed AAA diameter; c) improve health-related quality of life; and d) represent a cost-effective treatment to reduce the need for AAA surgery., Safety objective. To determine adverse events; primarily related to known side effects of metformin and possible unexpected effects on AAA, related to metformin treatment after two and five years treatment., Exploratory objectives. To examine; a) if there is a dose or time related response of metformin regarding the primary or secondary endpoints; and b) if metformin favorably modify circulating inflammation and matrix remodeling biomarkers; or c) affect perivascular adipose tissue.

Source: https://euclinicaltrials.eu/ctis-public/view/2024-517387-37-00